EU clinical trial 2026-525632-41-00: Randomized Controlled Trial Assessing the Effectiveness and Safety of Fecal Microbiota Transfer for VRE Eradication in Immunocompromised Patients (EU CTR, Phase II) – VRE-ex
Protocol code: TMP-19012026-1
Sponsor: Fraunhofer Institute For Translational Medicine And Pharmacology ITMP (Laboratory/Research/Testing facility). Phase: Therapeutic exploratory (Phase II). Countries: Germany (authorised, recruitment pending).
Therapeutic area(s): Diseases [C] - Bacterial Infections and Mycoses [C01]
Gender: Female, Male. Age: 18-64 years, 65+ years. Enrolment: 42.
Status: Authorised, recruitment pending. Decision date: 2026-07-21. Results received: No. Last updated: 2026-07-21.

Condition(s): Intestinal colonization with vancomycin-resistant enterococci (VRE)
Product: INTESTIFIX 001, MOVIPREP®, Pulver zur Herstellung einer Lösung zum Einnehmen, Placebo to INTESTIFIX 001

Primary endpoint: To assess the rate of VRE decolonization on day 30 of a two-dose FMT in comparison to placebo, as shown by two negative fecal cultures (stool sample and rectal swab) taken on two consecutive days.
Endpoint(s): To assess the rate of VRE decolonization on day 30 of a single dose FMT vs. placebo, as shown by two consecutive negative fecal cultures (stool sample and rectal swap) taken on two consecutive days., To assess the rate of VRE decolonization on day 90, To assess the rate of VRE decolonization on day 180, To assess the rate of strain-specific VRE decolonization by including data from whole genome sequencing on day 30, 90 and 180, To assess the rate of VRE decolonization on day 30, 90 and 180 when including enrichment broth culture results, To assess reduction in VRE bacterial burden on day 30, 90 and 180 as assessed by quantitative culture, To assess the oncological outcome within 3 and 6 months of FMT, To compare the decolonization rate of a two-dose FMT to single dose FMT on day 30, 90, 180, To monitor the incidence of VRE-related infections post-FMT, Comparison of safety data between patients with FMT or placebo via review of type, frequency and severity of adverse events (AEs), serious AEs (SAEs), and new medical conditions during 3-month follow-up period, Incidence of adverse events (AEs) and serious adverse events (SAEs) related to FMT, Post-FMT microbiota composition: intestinal microbiota changes in patients up to 180 days after FMT relative to baseline (before FMT), Post-FMT donor microbiota engraftment: Detection of donor-derived strains in the intestinal microbiota of patients after FMT, Donor strain engraftment prediction: Validation of algorithm to predict post-FMT microbiota assembly based on pre-FMT patient and donor microbiota composition, Engraftment assay: Correlation between in vitro engraftment assay using recipient or donor stool and recipient VRE isolates and the observed colonization outcome, Immune changes: shift in PBMC and microbiome-related plasma biomarker composition after FMT compared to baseline, Changes in the quality of life as reported with the EQ-5D-5L between baseline and day 30, 90, Treatment satisfaction (TS-VAS) as reported by patient on day 30

Source: https://euclinicaltrials.eu/ctis-public/view/2026-525632-41-00